EU clinical trial 2024-514769-20-00: Melatonin for patients with chronic low back pain (MELBACK) - a randomized placebo-controlled trial
Sponsor: Erasmus Universitair Medisch Centrum Rotterdam (Erasmus MC) (Hospital/Clinic/Other health care facility). Phase: Therapeutic confirmatory (Phase III). Countries: Netherlands (ongoing, recruitment ended).
Therapeutic area(s): Diseases [C] - Musculoskeletal Diseases [C05]
Gender: Female, Male. Age: 18-64 years. Enrolment: 240.
Status: Ongoing, recruitment ended. Start date (EU): 2025-03-02. Decision date: 2025-01-15. Results received: No. Last updated: 2025-01-15.

Condition(s): Chronic low back pain
Product: Lactose monohydrate, Melatonine Tiofarma 5 mg tabletten

Primary endpoint: The between-group difference in change in pain intensity (i.e. average pain intensity past 7 days) measured on a 0-10 NRS scale, from baseline to 6 weeks in patients with chronic LBP

Source: https://euclinicaltrials.eu/ctis-public/view/2024-514769-20-00